EU clinical trial 2024-517267-23-00: Botulinum toxin (BOTOX®) to prevent post-operative pancreatic fistula in patients who undergo distal pancreatectomy
Protocol code: NL68231.078.18
Sponsor: Erasmus Universitair Medisch Centrum Rotterdam (Erasmus MC) (Hospital/Clinic/Other health care facility). Phase: Phase I and Phase II (Integrated)- First administration to humans. Countries: Netherlands (ended).
Therapeutic area(s): Diseases [C] - Digestive System Diseases [C06]
Gender: Female, Male. Age: 18-64 years, 65+ years. Enrolment: 50.
Status: Ended. Start date (EU): 2019-11-11. End date (EU): 2026-01-13. Decision date: 2024-09-25. Results received: No. Last updated: 2024-09-25.

Condition(s): postoperative pancreatic fistulas
Product: BOTOX 100 Allergan Units Powder for Solution for Injection

Primary endpoint: The primary endpoint of this pilot project is to determine the feasibility and safety of preoperative endoscopic BOTOX® injection in the sphincter of Oddi. We deem this treatment feasible in case we can complete the proposed treatment in 14 out of 15 patients.
Endpoint(s): As a secondary endpoint we will investigate the effect of preoperative endoscopic BOTOX® injection in the sphincter of Oddi on the occurrence of postoperative pancreatic fistulas.

Source: https://euclinicaltrials.eu/ctis-public/view/2024-517267-23-00